EU clinical trial 2023-507008-30-00: Immunogenicity Profile of Neoadjuvant Keytruda in Combination with Anthracycline versus Carboplatin/PAclitaxel Containing Chemotherapy Regimen for The Treatment of Early-stage, TILs-Positive, Triple-Negative Breast CanceR (KeyPARTNER)
Sponsor: Champalimaud Clinical Centre (Hospital/Clinic/Other health care facility). Phase: Therapeutic exploratory (Phase II). Countries: Portugal (ongoing, recruiting).
Therapeutic area(s): Diseases [C] - Neoplasms [C04]
Gender: Female, Male. Age: 18-64 years, 65+ years. Enrolment: 20.
Status: Ongoing, recruiting. Start date (EU): 2024-04-17. Decision date: 2024-03-13. Results received: No. Last updated: 2025-06-27.

Condition(s): High risk (TILs-positive) HR-/HER2- (triple negative) breast cancer
Product: CARBOPLATIN, EPIRUBICIN, KEYTRUDA 25 mg/mL concentrate for solution for infusion, PEGFILGRASTIM, PACLITAXEL, DOXORUBICIN, CYCLOPHOSPHAMIDE, FILGRASTIM

Primary endpoint: Primary efficacy endpoint: Pathological complete response;, Primary translational endpoint: Fate bifurcation is defined as the proportion of TILs with the phenotype T-bet(hi) PD1(mid) CD8+. Quantification of number of T cells per mm2 with different phenotypes will be performed, and averages will be calculated per disease sampling (i.e., pre-treatment and C2D1), per arm and by pCR status.

Source: https://euclinicaltrials.eu/ctis-public/view/2023-507008-30-00